EU clinical trial 2022-502241-99-00: A Phase 1 Study to Evaluate the Safety and Target Engagement of EXL01 in the Maintenance of Steroid-induced Clinical Response or Remission in Patients with Mild to Moderate Crohn's Disease
Protocol code: EXL01-CD-001
Sponsor: Exeliom Biosciences (Pharmaceutical company). Phase: Human Pharmacology (Phase I)- First administration to humans. Countries: Belgium (ended), Poland (ended).
Therapeutic area(s): Diseases [C] - Digestive System Diseases [C06]
Gender: Female, Male. Age: 18-64 years, 65+ years. Enrolment: 50.
Status: Ended. Start date (EU): 2023-03-20. End date (EU): 2024-05-28. End date: 2024-05-28. Decision date: 2023-08-07. Results received: No. Last updated: 2023-11-24.
Decision dates by country: BE: 2023-08-07, PL: 2023-09-05

Condition(s): Crohn's Disease

Source: https://euclinicaltrials.eu/ctis-public/view/2022-502241-99-00